EU clinical trial 2023-507407-59-00: A Randomized, Double-Blind, Parallel Group, Multi-Center, Phase III Study to Assess the Efficacy of Budesonide, Glycopyrronium, and Formoterol Fumarate Metered-Dose Inhaler Relative to Glycopyrronium and Formoterol Fumarate MDI on Cardiopulmonary Outcomes in Chronic Obstructive Pulmonary Disease (THARROS)
Protocol code: D5989C00001 THARROS
Sponsor: Astrazeneca AB (Pharmaceutical company). Phase: Therapeutic confirmatory (Phase III). Countries: Hungary (ongoing, recruiting), Norway (ongoing, recruiting), Spain (ongoing, recruiting), Denmark (ongoing, recruiting), Slovakia (ongoing, recruiting), Bulgaria (ongoing, recruiting), Italy (ongoing, recruiting), Germany (ongoing, recruiting), France (ongoing, recruiting), Greece (ongoing, recruiting), Austria (ongoing, recruiting), Romania (ongoing, recruiting), Finland (ongoing, recruiting), Czechia (ongoing, recruiting), Sweden (ongoing, recruiting), Poland (ongoing, recruiting).
Therapeutic area(s): Diseases [C] - Respiratory Tract Diseases [C08]
Gender: Female, Male. Age: 18-64 years, 65+ years. Enrolment: 1365.
Status: Ongoing, recruiting. Start date (EU): 2024-07-04. Decision date: 2024-06-10. Results received: No. Last updated: 2026-08-06.
Decision dates by country: SK: 2024-06-12, IT: 2024-06-12, ES: 2024-06-11, FR: 2024-06-14, HU: 2024-06-11, CZ: 2024-06-11, AT: 2024-06-17, GR: 2024-06-17, PL: 2024-06-14, FI: 2024-06-11, DK: 2024-06-10, NO: 2024-06-12, DE: 2024-06-17, RO: 2024-06-17, SE: 2024-06-13, BG: 2024-06-17

Condition(s): Chronic Obstructive Pulmonary Disease (COPD)
Product: SALBUTAMOL, Bevespi Aerosphere 7.2 micrograms/5 micrograms pressurised inhalation, suspension, Trixeo Aerosphere 5 micrograms/7.2 micrograms/160 micrograms pressurised inhalation, suspension

Primary endpoint: Time to first severe cardiac or COPD event.
Endpoint(s): -Time to first severe COPD exacerbation -Time to first severe cardiac event -Time to cardiopulmonary death -moderate/severe COPD exacerbation rate -Time to MI hospitalization (or cardiac death) -Time to HF acute healthcare visit/hospitalization (or cardiac death)

Source: https://euclinicaltrials.eu/ctis-public/view/2023-507407-59-00